EU clinical trial 2023-509304-16-00: A Study Evaluating the Efficacy and Safety of Ralinepag to Improve Treatment Outcomes in PAH Patients (ADVANCE Outcomes)
Protocol code: ROR-PH-301
Sponsor: United Therapeutics Corp. (Pharmaceutical company). Phase: Therapeutic confirmatory (Phase III). Countries: Hungary (ended), Belgium (ended), France (ended), Germany (ended), Netherlands (ended), Romania (ended), Spain (ended), Czechia (ended), Denmark (ended), Poland (ended), Bulgaria (ended), Greece (ended), Italy (ended), Portugal (ended), Austria (ended).
Therapeutic area(s): Diseases [C] - Cardiovascular Diseases [C14]
Gender: Female, Male. Age: 18-64 years, 65+ years. Enrolment: 190.
Status: Ended. Start date (EU): 2019-05-16. End date (EU): 2026-01-21. End date: 2026-02-03. Decision date: 2024-06-12. Results received: No. Last updated: 2026-01-15.
Decision dates by country: AT: 2024-06-19, NL: 2024-06-17, IT: 2024-06-24, CZ: 2024-06-13, PL: 2024-07-22, ES: 2024-06-13, PT: 2024-07-02, DE: 2024-06-13, HU: 2024-06-12, GR: 2024-07-22, BG: 2024-07-02, RO: 2024-06-17, BE: 2024-06-13, DK: 2024-06-13, FR: 2024-06-12

Condition(s): Pulmonary arterial hypertension (PAH)
Product: Placebo for Ralinepag extended-release tablets, Ralinepag, Ralinepag, Ralinepag

Primary endpoint: The primary endpoint is the time from randomization to the first adjudicated protocol-defined worsening event. Subjects without a protocol-defined clinical worsening event will be censored at date of last contact, 7 days after last study dose, or end of study date, whichever is the earliest.
Endpoint(s): NT-proBNP with log transformation will be analyzed using MMRM analysis with treatment, the stratification factors, week, and treatment-by-week interaction as factors and baseline NT-proBNP as a covariate. Least squares means, standard errors (SE), and 95% CIs for the treatments and their difference will be presented together with the p-value., 6MWD will be analyzed using MMRM analysis with treatment measured>12 hours post dose, the stratification factors (less 6MWD stratum), week, and treatment-by-week interaction as factors and baseline 6MWD as a covariate. Least squares means, SEs, and 95% CIs for the treatments and their difference will be presented together with the p-value., WHO/NYHA functional class will be analyzed using using CMH method adjusted for baseline WHO/NYHA functional class and using modified ridit scores to compute the test statistic and p-value for the between treatment comparison., Time to first all-cause hospitalization will be analyzed using Cox regression with a model that includes treatment and the stratification factors. The hazard ratio for treatment together with its 95% CI and p-value will be presented., Time to all-cause mortality will be analyzed using Cox regression with a model that includes treatment and the stratification factors. The hazard ratio for treatment together with its 95% CI and p-value will be presented., HRR following completion of 6MWT will be analyzed using MMRM analysis with treatment, the stratification factors, week, and treatment-by-week interaction as factors and baseline HRR as a covariate. Least squares means, SEs, and 95% CIs for the treatments and their difference will be presented together with the p-value., The proportion of subjects who achieve all three of the following: NT-proBNP <300 pg/mL, 6MWD >440 m, WHO/NYHA functional class I or II status or better will be analyzed using CMH method. The odds ratio will be presented together with 95% CIs and the p-value., REVEAL score will be analyzed using MMRM analysis with treatment, the stratification factors, week, and treatment-by-week interaction as factors and baseline REVEAL score as a covariate. Least squares means, SEs, and 95% CIs for the treatments and their difference will be presented together with the p-value., HRQoL measures (SF-36) will be analyzed using MMRM analysis with treatment, the stratification factors, week, and treatment-by-week interaction as factors and baseline domain score as a covariate. Least squares means, SEs, and 95% CIs for the treatments and their difference will be presented together with the p-value.

Source: https://euclinicaltrials.eu/ctis-public/view/2023-509304-16-00